EU clinical trial 2023-507600-32-00: A Phase 3, randomized, modified double-blind, active-controlled, parallel-group, 2-arm study to investigate the safety and immunogenicity of a 21-valent pneumococcal conjugate vaccine in healthy infants and toddlers
Protocol code: PSK04
Sponsor: Sanofi Pasteur Inc. (Pharmaceutical company). Phase: Therapeutic confirmatory (Phase III). Countries: Italy (ongoing, recruitment ended), Poland (ongoing, recruitment ended), Finland (ongoing, recruitment ended), Netherlands (ended), Greece (ongoing, recruitment ended), Belgium (ongoing, recruitment ended), Germany (ongoing, recruitment ended), Czechia (ongoing, recruitment ended), Estonia (ongoing, recruitment ended).
Therapeutic area(s): Diseases [C] - Bacterial Infections and Mycoses [C01]
Gender: Female, Male. Age: 0-17 years. Enrolment: 1113.
Start date (EU): 2025-05-22. Decision date: 2025-03-25. Results received: No. Last updated: 2026-06-08.
Decision dates by country: NL: 2025-03-28, IT: 2025-03-26, GR: 2025-03-28, CZ: 2025-03-25, DE: 2025-03-27, BE: 2025-03-25, FI: 2025-03-31, EE: 2025-03-27, PL: 2025-03-27

Condition(s): Pneumococcal Immunization
Product: Pneumococcal Conjugate Vaccine (PCV), Vaxneuvance suspension for injection in pre-filled syringe Pneumococcal polysaccharide conjugate vaccine (15-valent, adsorbed)

Primary endpoint: Seroresponse rate for PCV21 and 15vPCV serotypes, IgG concentration for PCV21 and 15vPCV serotypes
Endpoint(s): Anti- hepatitis B surface antigen (HBsAg) Ab, Anti- polyribosylribitol phosphate (PRP) Ab, Anti-poliovirus types (1, 2, and 3) Ab, Anti-diphtheria Ab concentrations, Anti-tetanus Ab concentrations, Anti-pertussis Ab concentrations (Pertussis toxin (PT) and Filamentous Hemagglutinin (FHA)), Anti-measles Ab concentrations, Anti-mumps Ab concentrations, Anti-rubella Ab concentrations, Anti-varicella Ab concentrations, Anti HBsAg concentrations, Anti-PRP Ab concentrations, Anti-poliovirus types (1, 2, and 3) Ab titers, Anti-diphtheria Ab concentrations, Anti-tetanus Ab concentrations, Anti-pertussis Ab concentrations (PT and FHA), Serotype specific OPA titers for all serotypes included in PCV21, Serotype specific OPA titers for all serotypes included in PCV21, Presence of any immediate adverse events (AEs), Presence of solicited injection site and systemic reactions through 7 days after each vaccine injection, Presence of unsolicited (spontaneously reported) injection site reactions and unsolicited systemic AEs through 30 days after each vaccine injection, Presence of serious adverse events (SAEs) throughout the study (through 6 months post- last vaccine injection), Presence adverse events of special interest (AESIs) throughout the study (through 6 months post- last vaccine injection)

Source: https://euclinicaltrials.eu/ctis-public/view/2023-507600-32-00